EU clinical trial 2024-514524-16-00: Prospective, multicentre, randomized, double-blind, placebo-controlled, clinical trial of efficacy and safety with subcutaneous immunotherapy in patients with rhinitis/rhinoconjunctivitis with or without mild to moderate asthma sensitized to grasses and cupressaceae
Protocol code: DMV02-SIT-026
Sponsor: Inmunotek S.L. (Pharmaceutical company). Phase: Therapeutic confirmatory (Phase III). Countries: Spain (ongoing, recruiting).
Therapeutic area(s): Diseases [C] - Immune System Diseases [C20]
Gender: Female, Male. Age: 0-17 years, 18-64 years. Enrolment: 180.
Status: Ongoing, recruiting. Start date (EU): 2021-05-11. Decision date: 2024-08-14. Results received: No. Last updated: 2025-09-05.

Condition(s): Aetiological treatment of moderate-severe intermitent or persistent allergic rhinitis/rhinoconjunctivitis with or without controlled mild-moderate intermittent or persistent allergic asthma
Product: Identical solution and presentation as the active treatment, but without active ingredients., Mixture of modified allergen extracts of 6 grasses (MG01) and modified allergen extract of Juniperus oxycedrus (T521), Mixture of modified allergen extracts of 6 grasses (MG01) and modified allergen extract of Juniperus oxycedrus (T521)

Primary endpoint: Combined symptom and medication score in rhinitis/rhinoconjunctivitis (RCSMS) during the pollen season and pollen peak of cupressaceae (January, February and March) and grasses (May and June).
Endpoint(s): Symptom free days in rhinitis/rhinoconjunctivitis and asthma, Medication-free days in rhinitis/rhinoconjunctivitis and asthma, Symptom score in rhinitis/rhinoconjunctivitis (RSS) during pollen season and pollen peak of grasses and cupressaceae., Medication score in rhinitis/rhinoconjunctivitis (RMS) during pollen season and pollen peak of grasses and cupressaceae., Combined symptom and medication score (ACSMS) during pollen season and pollen peak of grasses and cupressaceae., Asthma symptom score (ASS) during pollen season and pollen peak of grasses and cupressaceae., Asthma Medication Score (AMS) during pollen season and pollen peak of grasses and cupressaceae., Asthma and rhinitis/rhinoconjunctivitis symptom score (ARSS) during pollen season and pollen peak of grasses and cupressaceae., Asthma and rhinitis/rhinoconjunctivitis medication score (ARMS) during pollen season and pollen peak of grasses and cupressaceae, Combined symptom and medication score in asthma and rhinitis/rhinoconjunctivitis (ARCSMS) during pollen season and pollen peak of grasses and cupressaceae., Asthmatic exacerbations: time to first occurrence of asthmatic exacerbation, number, duration and severity., Visual Analogue Scale (VAS), Immunological parameters (total IgE, specific IgE and specific IgG4)., Asthma Control Questionnaire (ACQ-6)., Rhinitis Follow-up Questionnaire (ESPRINT-15)., Register of consumption of health resources., Safety of specific immunotherapy (Overall rate, severity, and ratio of any adverse event (AE) by administration and by subject; Evaluation of administration site reactions, systemic reactions and any medication administered for the treatment of AE)

Source: https://euclinicaltrials.eu/ctis-public/view/2024-514524-16-00